EU clinical trial 2024-512900-20-00: A Phase 1/2 Study of EG-70 as an Intravesical Administration to Patients with BCG-Unresponsive Non-Muscle Invasive Bladder Cancer (NMIBC) and High-Risk NMIBC Patients who are BCG Naïve or Received Incomplete BCG Treatment
Protocol code: EG-70-101
Sponsor: Engene Inc. (Pharmaceutical company). Phase: Phase I and Phase II (Integrated)- First administration to humans. Countries: Germany (ongoing, recruiting), France (ongoing, recruiting), Spain (ongoing, recruiting), Italy (ongoing, recruiting).
Therapeutic area(s): Diseases [C] - Neoplasms [C04]
Gender: Female, Male. Age: 18-64 years, 65+ years. Enrolment: 79.
Status: Ongoing, recruiting. Start date (EU): 2025-01-30. Decision date: 2024-12-23. Results received: No. Last updated: 2026-05-26.
Decision dates by country: IT: 2025-01-09, FR: 2024-12-23, DE: 2024-12-30, ES: 2024-12-23

Condition(s): Non-muscle invasive bladder cancer (NMIBC)

Primary endpoint: Percentage of patients with cystoscopic CR at any time, based on cystoscopic exam, urine cytology, and biopsies. Investigator assessment of response will be reviewed by central pathology laboratory adjudication (for NMIBC cohorts with CIS) when corresponding specimen is available for review.
Endpoint(s): Progression-free survival, Recurrence-free survival for the NMIBC papillary-only cohort (Cohort 3)., Duration of response of the responding patients and percentage of patients with duration of response ≥ 1 year., Cystectomy-free survival., CR rate at landmark timepoints., Health-related Quality of Life (EORTC Quality of Life Questionnaire Core 30 [QLQ-C30] and NMIBC-24), Other endpoints: Anti-drug antibodies, EG-70 plasmid DNA in urine and blood, levels of IL-12 gene expression and RIG-I activators and/or biomarkers in specimens, Nature, incidence, relatedness, and severity of treatment-emergent AEs (as assessed by CTCAE v5.0).

Source: https://euclinicaltrials.eu/ctis-public/view/2024-512900-20-00